EU clinical trial 2024-514364-54-00: Double-blind, randomised clinical study comparing efficacy and safety of Mecloderm® Cream (Test) vs. Lotricomb® Cream (Reference) vs. Vehicle in patients with moderate to severely inflamed candidiasis of the skin
Protocol code: 18-02/ClotriBet-C
Sponsor: Dermapharm AG (Pharmaceutical company). Phase: Therapeutic confirmatory (Phase III). Countries: Germany (ongoing, recruiting).
Therapeutic area(s): Diseases [C] - Skin and Connective Tissue Diseases [C17]
Gender: Female, Male. Age: 18-64 years, 65+ years. Enrolment: 552.
Status: Ongoing, recruiting. Start date (EU): 2021-10-18. Decision date: 2024-08-14. Results received: No. Last updated: 2026-07-06.

Condition(s): moderate to severely inflamed candidiasis of the skin

Source: https://euclinicaltrials.eu/ctis-public/view/2024-514364-54-00